EU clinical trial 2023-507637-19-00: A Study Assessing Adverse Event and How Oral ABBV-453 Moves Through the Body in Adult Participants with Relapsed or Refractory (R/R) Chronic Lymphocytic Leukemia (CLL)/Small Lymphocytic Lymphoma (SLL)
Protocol code: M24-291
Sponsor: AbbVie Deutschland GmbH & Co. KG (Pharmaceutical company). Phase: Human Pharmacology (Phase I)- Other. Countries: Italy (ongoing, recruitment ended), Germany (ended).
Therapeutic area(s): Diseases [C] - Neoplasms [C04]
Gender: Female, Male. Age: 18-64 years, 65+ years. Enrolment: 26.
Start date (EU): 2024-10-15. Decision date: 2024-08-23. Results received: No. Last updated: 2026-01-26.
Decision dates by country: DE: 2024-08-26, IT: 2024-08-23

Condition(s): Small Lymphocytic Lymphoma, Chronic Lymphocytic Leukemia

Source: https://euclinicaltrials.eu/ctis-public/view/2023-507637-19-00